EU clinical trial 2023-503327-26-00: A Phase 3, Randomized, Double-blind, Placebo-controlled Study to Evaluate the Efficacy and Safety of Deucravacitinib in Adults with Active Sjögren’s Syndrome (POETYK SjS-1)
Protocol code: IM011-1069
Sponsor: Bristol-Myers Squibb Services Unlimited Company (Pharmaceutical company). Phase: Therapeutic confirmatory (Phase III). Countries: Germany (ongoing, recruiting), Italy (ongoing, recruiting), Poland (ongoing, recruiting), Sweden (ongoing, recruiting), Greece (ongoing, recruiting), Romania (ongoing, recruiting), France (ongoing, recruiting), Belgium (ongoing, recruiting), Hungary (ongoing, recruiting), Portugal (ongoing, recruiting), Netherlands (ongoing, recruiting), Spain (ongoing, recruiting), Austria (ongoing, recruiting), Bulgaria (ongoing, recruiting), Finland (ongoing, recruiting).
Therapeutic area(s): Diseases [C] - Immune System Diseases [C20]
Gender: Female, Male. Age: 18-64 years, 65+ years. Enrolment: 243.
Status: Ongoing, recruiting. Start date (EU): 2024-01-31. Decision date: 2023-12-05. Results received: No. Last updated: 2026-07-20.
Decision dates by country: NL: 2023-12-11, FI: 2024-10-07, IT: 2023-12-06, PL: 2023-12-06, FR: 2023-12-07, HU: 2023-12-11, GR: 2023-12-11, BE: 2023-12-11, AT: 2023-12-11, ES: 2023-12-11, RO: 2023-12-11, DE: 2023-12-05, PT: 2023-12-11, SE: 2023-12-07, BG: 2023-12-11

Condition(s): Sjogren's syndrome
Product: Deucravacitinib placebo 3 mg film-coated tablets oral use, Deucravacitinib placebo 6 mg film-coated tablets oral use, deucravacitinib, deucravacitinib

Primary endpoint: Change from baseline in ESSDAI at Week 52
Endpoint(s): Change from baseline in ESSPRI at Week 52, Proportion of participants with decrease in ESSPRI ≥ 1 or 15% from baseline at Week 52, Proportion of participants with decrease in ESSDAI ≥ 3 points from baseline at Week 52, Proportion of participants with ESSDAI < 5 at Week 52, Change from baseline in ESSDAI at Week 24, Change from baseline in SWSF at Week 52, Change from baseline in PhGA at Week 52, Change from baseline in FACIT-Fatigue at Week 52, Change from baseline in ocular dryness NRS at Week 52, Change from baseline in oral dryness NRS at Week 52, Change from baseline in joint/muscle pain NRS at Week 52, Incidence of AEs, SAEs, AEs leading to discontinuation of treatment and study discontinuation, and target AEIs; change in laboratory, ECG, and vital signs; and abnormalities in laboratory, ECG, and vital signs, Proportion of participants with increase of Schirmer's test ≥ 5 mm if abnormal baseline or No change of Schirmer's test to abnormal if normal baseline at Week 52

Source: https://euclinicaltrials.eu/ctis-public/view/2023-503327-26-00